EU clinical trial 2024-513843-10-00: 68Ga-SATO in paediatric neuroblastoma patients; exploratory, safety, non-randomized, open label, comparative study - GAP NBL study
Protocol code: PS21GAP
Sponsor: Prinses Maxima Centrum voor Kinderoncologie B.V. (Hospital/Clinic/Other health care facility). Phase: Phase I and Phase II (Integrated)- Other. Countries: Netherlands (temporarily halted).
Therapeutic area(s): Diseases [C] - Neoplasms [C04]; Analytical, Diagnostic and Therapeutic Techniques and Equipment [E] - Diagnosis [E01]
Gender: Female, Male. Age: 0-17 years. Enrolment: 20.
Status: Temporarily halted. Start date (EU): 2023-02-28. Decision date: 2024-10-11. Results received: No. Last updated: 2025-06-17.

Condition(s): neuroblastoma
Product: IOBENGUANE (123I), 68Ga-SSO120

Primary endpoint: To assess the short term safety and tolerability of 68Ga-SATO, according to CTCAE v5.0.
Endpoint(s): Comparison of 68Ga-SATO PET/CT imaging to the current clinical standard of M123IBG scintigraphy in NBL patients, in terms of lesions detection., Comparison of 68Ga-SATO PET/CT imaging to whole body MRI (in case available), in terms of lesions detection., To calculate, in a subset of patients, the radiation absorbed dose of 68Ga-SATO for patients using dynamic PET imaging., Evaluation of procedure time for the preparations and acquisition of a 68Ga-SATO

Source: https://euclinicaltrials.eu/ctis-public/view/2024-513843-10-00